EU clinical trial 2023-504023-63-00: Open-label, prospective study to assess the safety, tolerability, analgesic effect and feasibility of IN SUF/KET in pediatric patients with moderate or severe pain, in an acute care setting
Protocol code: PDC 01-0202
Sponsor: Cessatech A/S (Pharmaceutical company). Phase: Therapeutic exploratory (Phase II). Countries: Spain (ended).
Therapeutic area(s): Analytical, Diagnostic and Therapeutic Techniques and Equipment [E] - Anesthesia and Analgesia [E03]
Gender: Female, Male. Age: 0-17 years. Enrolment: 75.
Status: Ended. Start date (EU): 2024-05-24. End date (EU): 2025-05-09. Decision date: 2023-10-09. Results received: Yes. Last updated: 2024-11-18.

Condition(s): Pain

Primary endpoint: Analgesic efficacy will be assessed as changes in pain intensity from baseline using age relevant scoring instruments (FLACC score for ages ≥ 1 year to < 5 years, the Wong-Baker faces scale from ages ≥ 5 years to < 9 years, and the 0-10 Numerical Rating Scale (NRS) from ages 9 and above).
Endpoint(s): Maximum change in pain intensity within 30 min post IMP administration., Number and proportion of participants that achieve a 30% reduction in pain intensity within 30 min post IMP., Change in pain intensity at 10, 15, 20, 30, 45 and 60 min post IMP., Derived variables such as area under curve (AUC), peak change in pain intensity, and duration of effect will be calculated from the recorded pain assessments., Number of children receiving additional analgesics, as assessed by timepoint.

Source: https://euclinicaltrials.eu/ctis-public/view/2023-504023-63-00